EU clinical trial 2023-507772-50-00: PSMAfore: A phase III, Open-label, Multi-Center, Randomized Study Comparing 177Lu-PSMA-617 vs. a Change of androgen receptor-directed therapy in the Treatment of Taxane Naïve Men with Progressive Metastatic Castrate Resistant Prostate Cancer
Protocol code: CAAA617B12302
Sponsor: Novartis Pharma AG (Pharmaceutical company). Phase: Therapeutic confirmatory (Phase III). Countries: Spain (ongoing, recruitment ended), Slovakia (ongoing, recruitment ended), Czechia (ongoing, recruitment ended), Sweden (ongoing, recruitment ended), Belgium (ongoing, recruitment ended), France (ended), Austria (ended), Germany (ongoing, recruitment ended), Netherlands (ended).
Therapeutic area(s): Diseases [C] - Neoplasms [C04]
Gender: Male. Age: 18-64 years, 65+ years. Enrolment: 334.
Start date (EU): 2021-06-16. Decision date: 2024-01-30. Results received: No. Last updated: 2026-06-23.
Decision dates by country: BE: 2024-02-01, CZ: 2024-02-05, DE: 2024-03-12, FR: 2024-01-30, NL: 2024-01-31, AT: 2024-03-07, SK: 2024-01-30, SE: 2024-02-01, ES: 2024-01-31

Condition(s): PSMA-positive metastatic castration-resistant prostate cancer
Product: ABIRATERONE ACETATE, ABIRATERONE ACETATE, Pluvicto 1 000 MBq/mL solution for injection/infusion, ABIRATERONE ACETATE, ENZALUTAMIDE, ENZALUTAMIDE, Locametz 25 micrograms kit for radiopharmaceutical preparation, ENZALUTAMIDE

Primary endpoint: Radiographic progression-free survival (rPFS) is defined as the time from the date of randomization to the date of first documented radiographic disease progression as assessed by blinded independent central review (BICR) and as outlined in Prostate Cancer Working Group 3 (PCWG3) Guidelines (Scher et al 2016) or death due to any cause.
Endpoint(s): OS: Time from randomization to death due to any cause, rPFS2 defined as time from the date of crossover (ARDT to 177Lu-PSMA-617) to the date of radiographic disease progression by BICR or death from any cause [rPFS definition as outlined in PCWG3 guidelines], PFS defined as time from date of randomization to the first documented progression by investigator's assessment (radiographic, clinical, or PSA progression) or death from any cause, whichever occurs first, PFS2 defined as time from date of randomization to the first documented progression by investigator's assessment (radiographic progression, clinical progression, PSA progression) or death from any cause, whichever occurs first, on next-line of therapy, PSA50 defined as proportion of participants who achieved a ≥ 50% decrease from baseline that is confirmed by a second PSA measurement ≥ 4 weeks. PSA50 will be evaluated at 3, 6 and 12 months., Time to SSE (TTSSE) defined as date of randomization to the date of first new symptomatic pathological bone fracture, spinal cord compression, tumor-related orthopedic surgical intervention, requirement for radiation therapy to relieve bone pain or death from any cause, whichever occurs first, Time to soft tissue progression (TTSTP) defined as time from randomization to radiographic soft tissue progression per PCWG3-modified RECIST v1.1 (Soft Tissue Rules of Prostate Cancer Working Group modified Response Evaluation Criteria in Solid Tumors Version 1.1) as Assessed by Blinded Independent Central Review (BICR), Time to chemotherapy (TTCT) defined as time from randomization to initiation of the first subsequent chemotherapy or death, whichever occurs first, HRQoL as assessed by EQ-5D-5L, FACT-P and BPI-SF, Frequency of adverse events, safety laboratory assessments and vital signs

Source: https://euclinicaltrials.eu/ctis-public/view/2023-507772-50-00